EU clinical trial 2024-518345-21-00: Evaluation of the effects of bosentan in the management of patients in the acute phase of acute anterior ischemic optic neuropathy.
Protocol code: 38RC12.228
Sponsor: Centre Hospitalier Universitaire Grenoble Alpes (Hospital/Clinic/Other health care facility). Phase: Therapeutic confirmatory (Phase III). Countries: France (ongoing, recruitment ended).
Therapeutic area(s): Diseases [C] - Eye Diseases [C11]
Gender: Female, Male. Age: 18-64 years, 65+ years. Enrolment: 94.
Status: Ongoing, recruitment ended. Start date (EU): 2015-07-31. Decision date: 2024-10-30. Results received: No. Last updated: 2024-10-30.

Condition(s): early stage of acute non-arteritic anterior ischemic optic neuropathy
Product: Bosentan/Mylan 125 mg επικαλυμμένα με λεπτό υμένιο δισκία, Bosentan/Mylan 62,5 mg επικαλυμμένα με λεπτό υμένιο δισκία

Primary endpoint: Average deficit (in decibels) in automated visual field 30/2
Endpoint(s): the thickness of the optic fiber layer in SD OCT of the affected eye, visual acuity (ETDRS scale) and visual field parameters, evaluation of the following inflammation biomarkers: RANTES, MCP-1, TNF-α, INF-γ, IL-6, IL-10 and TGF, daytime and nighttime blood pressure values and variations at Baseline, automated visual field (mean deviation in Humphrey 30-2 and 60-4 sita-standard test, in dB) for healthy eye and NOIAA eye, plasma assay for prepro-endothelin, rate of bilateralization of the contralateral eye (occurrence of NOIAA) at 24 months, quality of life questionnaire (French version of VFQ-25)

Source: https://euclinicaltrials.eu/ctis-public/view/2024-518345-21-00